EU clinical trial 2024-515702-63-00: A Phase 3, Randomized, Double-masked, Placebo-controlled, Parallel-group, Multicenter Trial to Evaluate the Efficacy, Safety and Tolerability of Subcutaneous Teprotumumab in Participants with Moderate-to-Severe Active Thyroid Eye Disease
Protocol code: HZNP-TEP-305
Sponsor: Horizon Therapeutics USA Inc. (Pharmaceutical company). Phase: Therapeutic confirmatory (Phase III). Countries: Germany (ongoing, recruitment ended), Spain (ongoing, recruitment ended), France (ended), Italy (ongoing, recruitment ended), Poland (not authorised).
Therapeutic area(s): Diseases [C] - Eye Diseases [C11]
Gender: Female, Male. Age: 18-64 years, 65+ years. Enrolment: 31.
Start date (EU): 2025-02-20. Decision date: 2025-01-15. Results received: No. Last updated: 2026-07-10.
Decision dates by country: PL: 2025-01-20, FR: 2025-01-16, IT: 2025-01-27, DE: 2025-01-17, ES: 2025-01-27

Condition(s): Moderate-to-Severe Active Thyroid Eye Disease
Product: placebo for teprotumumab administered SC, Teprotumumab

Primary endpoint: Proptosis responder rate (percentage of participants with a ≥ 2-mm reduction from Baseline in proptosis in the study eye without deterioration [≥ 2-mm increase] of proptosis in the fellow eye) at XX Week
Endpoint(s): Mean change from Baseline at Week XX in proptosis measurement in the study eye., Overall responder rate (percentage of participants with ≥ 2-point reduction in Clinical Activity Score [CAS] AND ≥ 2-mm reduction in proptosis from Baseline, provided there is no corresponding deterioration [≥ 2-point/mm increase] in CAS or proptosis in the fellow eye) at Week XX., Percentage of participants with a CAS value of 0 or 1 at Week XX in the study eye., Change from Baseline at Week XX in diplopia as ordinal response categories., Diplopia responder rate, defined as the percentage of participants with Baseline binocular diplopia > 0 who have a reduction of ≥ 1 grade at Week XX, Complete diplopia responder rate, defined as the percentage of participants with a Baseline binocular diplopia score > 0 and a score of 0 at Week XX, Mean change from Baseline at Week XX in the Graves’ Ophthalmopathy Quality of Life (GO-QoL) questionnaire overall score

Source: https://euclinicaltrials.eu/ctis-public/view/2024-515702-63-00